EU clinical trial 2024-516807-17-00: Phase II trial of nivolumab for pediatric and adult relapsing/refractory ALK+ anaplastic large cell lymphoma, for evaluation of response in patients with progressive disease (Cohort 1) or as consolidative immunotherapy in patients in complete remission after relapse (Cohort 2) - NIVO ALCL
Protocol code: CSET N°2018/2706
Sponsor: Institut Gustave Roussy (Hospital/Clinic/Other health care facility). Phase: Therapeutic exploratory (Phase II). Countries: France (ongoing, recruitment ended), Denmark (ongoing, recruitment ended).
Therapeutic area(s): Diseases [C] - Neoplasms [C04]
Gender: Female, Male. Age: 0-17 years, 18-64 years. Enrolment: 43.
Status: Ongoing, recruitment ended. Start date (EU): 2019-01-02. Decision date: 2024-09-25. Results received: No. Last updated: 2024-09-25.
Decision dates by country: FR: 2024-09-25, DK: 2024-09-25

Condition(s): Relapsing/Refractory ALK+ Anaplastic Large cell Lymphoma
Product: OPDIVO 10 mg/mL concentrate for solution for infusion.

Primary endpoint: Cohort 1: Best objective response rate (CR+PR) within the first 24 weeks according to adapted Lugano 2014 Criteria for Malignant Lymphoma. In case of PET-positive residual masses after 24 weeks of induction treatment, a resection/biopsy must be performed by week 24. A residual mass proven to be pathologically negative for disease after resection or limited biopsy is considered as CR after discussion with the Coordinating investigator., Cohort 2: PFS. PFS is defined as the time since the inclusion in the trial to the first event among relapse and death (whatever the cause of death).
Endpoint(s): Efficacy: Cohort 1 -Time between the first dose of treatment and the confirmed CR/PR according to adapted Lugano 2014 Criteria for Malignant Lymphoma -Duration of response (CR/PR), defined as the time between the CR or PR according to adapted Lugano 2014 Criteria for Malignant Lymphoma (first met of these criteria) until confirmed progression or death • Best objective response rate (CR+PR) according to adapted Lugano 2014 Criteria for Malignant Lymphoma - Progression-free survival (PFS), Efficacy : Cohort 2 : Overall survival • PFS and OS in the subgroup of patients having received less than 12 months of ALK inhibitor or brentuximab • Minimal Residual Disease blood level at various time-points, Safety in cohorts 1 and 2: • Acute toxicity (NCI-CTCAE v5) during induction treatment, during maintenance treatment, and one month after the end of treatment Long-term toxicity (toxicity during the off-therapy period up to 5 years after study inclusion), Biology in cohorts 1 and 2: • Anti-ALK antibody blood level at various time-points • Biomarkers on tumor and its microenvironment, blood and bone marrow, including PDL1 and PDL2 expression, and tumor infiltrating lymphocytes and leucocytes populations/cytokines, at different time points.

Source: https://euclinicaltrials.eu/ctis-public/view/2024-516807-17-00